EU clinical trial 2024-518369-92-00: A Long-term Follow-up Study for Subjects Previously Treated with Autologous ex vivo Lentiviral Hematopoietic Stem and Progenitor Cell Gene Therapy for Wiskott-Aldrich Syndrome (WAS)
Protocol code: WAS-TLT003-01
Sponsor: Fondazione Telethon Ets (Patient organisation/association). Phase: Therapeutic confirmatory (Phase III). Countries: Italy (ongoing, recruiting).
Therapeutic area(s): Diseases [C] - Immune System Diseases [C20]
Gender: Female, Male. Age: 0-17 years, 18-64 years, 65+ years. Enrolment: 38.
Status: Ongoing, recruiting. Start date (EU): 2025-06-25. Decision date: 2025-04-11. Results received: No. Last updated: 2025-06-19.

Condition(s): Wiskott-Aldrich syndrome (WAS)
Product: OTL-103, OTL-103

Primary endpoint: To characterize the long-term safety of the gene therapy treatment with Telethon003 as measured by: recording of adverse event (AE) and serious adverse event (SAE) related to gene therapy including: − insertional mutagenesis and oncogenesis (blood and solid malignancies); − transgene immunogenicity; − development of replication-competent lentiviruses (RCL);, To evaluate the overall survival (OS) as primary efficacy endpoint up to 15 years of follow-up post treatment with Telethon003
Endpoint(s): Event free survival, Annualized rate of severe infections compared with 1 year prior to gene therapy;, Annualized rate of moderate and severe bleeding episodes compared with 1 year prior to gene therapy, Eczema, Autoimmunity, Hematologic disorders (i.e. neutropenia and/or other cytopenias);, Malignancies, Use of IgRT, New or exacerbations of pre-existing neurological disorders, Variation in height and weight (for paediatric patients), Karnofsky/Lansky performance scales, Platelet count and MPV, Vector Copy Number (VCN), Insertion site analysis (ISA), PedsQL (Pediatric Quality of Life Inventory) health-related quality of life scales, EQ-5D, and SF-10 or SF-36 health-related quality of life questionnaires

Source: https://euclinicaltrials.eu/ctis-public/view/2024-518369-92-00